EU clinical trial 2022-502743-35-00: B-cell depletion for the treatment of patients with amyotrophic lateral sclerosis (ALS) - A Randomized, Double-blind, Placebo controlled Pilot Study in Patients with Amyotrophic Lateral Sclerosis for the Evaluation of Efficacy and Safety of B-Cell Depletion with Rituximab (ABCD)
Protocol code: RituxALS01
Sponsor: Deutsches Zentrum Fuer Neurodegenerative Erkrankungen e.V. (Laboratory/Research/Testing facility). Phase: Therapeutic exploratory (Phase II). Countries: Germany (ongoing, recruiting).
Therapeutic area(s): Diseases [C] - Nervous System Diseases [C10]
Gender: Female, Male. Age: 18-64 years, 65+ years. Enrolment: 52.
Status: Ongoing, recruiting. Start date (EU): 2024-04-22. Decision date: 2023-05-15. Results received: No. Last updated: 2025-12-19.

Condition(s): Sporadic Amyotrophic Lateral Sclerosis
Product: Rixathon 500 mg concentrate for solution for infusion, Isotonische Kochsalzlösung Fresenius Infusionslösung, Paracetamol B. Braun 10 mg/ml Infusionslösung, Histakut Dimetindenmaleat 1 mg/ml Injektionslösung, Methylprednisolon acis 1000 mg Pulver und Lösungsmittel zur Herstellung einer Injektions- bzw. Infusionslösung

Primary endpoint: ALS Functional Rating Scale - Revised – self-explenatory (ALSFRS-R-SE) change from baseline (first dose of study drug) to 79 weeks after administration of the first dose compared to standard therapy riluzole alone
Endpoint(s): ALSFRS-R-SE change from baseline to 3, 27, 53, 105 and 131 weeks, Change in the slow vital capacity score (pulmonary fuction test) from baseline to 79 weeks, Change of BMI from baseline to 79 weeks, Tracheostomy-free survival at 79 weeks, Overall survival in Rituximab and standard therapy group, Laboratory parameters evaluating the safety of treatment with Rituximab, Serum and cerebrospinal fluid analyses with cell count, cytology, protein, glucose, lactate and infection markers, B cell counts, Neuropsychological tests (ECAS), Quality of Life questionnaire

Source: https://euclinicaltrials.eu/ctis-public/view/2022-502743-35-00